EU clinical trial 2025-522511-42-00: A multinational, multicenter extension study to investigate the long-term safety, tolerability and efficacy of balinatunfib in adults with Crohn’s disease or ulcerative colitis
Protocol code: LTS19689
Sponsor: Sanofi-Aventis Recherche & Developpement (Pharmaceutical company). Phase: Therapeutic exploratory (Phase II). Countries: Belgium (authorised, recruitment pending), Germany (authorised, recruitment pending), Czechia (ongoing, recruitment ended), Netherlands (authorised, recruitment pending), Spain (authorised, recruitment pending), Austria (authorised, recruitment pending), Italy (ongoing, recruitment ended), Greece (authorised, recruitment pending), Croatia (authorised, recruitment pending), Bulgaria (ongoing, recruitment ended), Poland (authorised, recruitment pending), France (authorised, recruitment pending), Romania (authorised, recruitment pending), Hungary (authorised, recruitment pending).
Therapeutic area(s): Diseases [C] - Digestive System Diseases [C06]
Gender: Female, Male. Age: 18-64 years, 65+ years. Enrolment: 131.
Start date (EU): 2026-05-19. Decision date: 2026-03-06. Results received: No. Last updated: 2026-07-02.
Decision dates by country: AT: 2026-03-09, BE: 2026-03-06, BG: 2026-03-13, HR: 2026-03-16, CZ: 2026-03-09, FR: 2026-03-11, DE: 2026-03-09, GR: 2026-03-10, HU: 2026-04-14, IT: 2026-03-10, RO: 2026-03-16, ES: 2026-03-09, NL: 2026-03-09, PL: 2026-04-13

Condition(s): Crohn's disease, Colitis Ulcerative
Product: Balinatunfib, Not the same excipients as test

Primary endpoint: Number of participants with Crohn's Disease with treatment emergent adverse events (TEAEs), serious adverse events (SAEs) and adverse events of special interest (AESIs), Number of participants with ulcerative colitis with treatment emergent adverse events (TEAEs), serious adverse events (SAEs) and adverse events of special interest (AESIs)
Endpoint(s): Proportion of participants with Crohn's Disease in endoscopic remission based on simple endoscopic score for Crohn’s disease (SES-CD), Proportion of participants with Crohn's Disease in endoscopic remission based on simple endoscopic score for Crohn’s disease (SES-CD), Proportion of participants with Crohn's Disease in clinical remission based on Crohn’s disease activity index (CDAI), Proportion of participants with Crohn's Disease in clinical remission based on Crohn’s disease activity index (CDAI), Proportion of participants with ulcerative colitis in clinical remission based on modified Mayo Score (mMS), Proportion of participants with ulcerative colitis in clinical remission based on modified Mayo Score (mMS)

Source: https://euclinicaltrials.eu/ctis-public/view/2025-522511-42-00